EU clinical trial 2023-503519-13-00: A Phase 2, Randomized, Open-label Study of Relatlimab in Combination with Nivolumab in Participants with Advanced Hepatocellular Carcinoma who are Naive to IO Therapy but Progressed on Tyrosine Kinase Inhibitors (RELATIVITY-073)
Protocol code: CA224-073
Sponsor: Bristol Myers Squibb International Corporation (Pharmaceutical company). Phase: Therapeutic exploratory (Phase II). Countries: Romania (ended), Poland (ended), Spain (ended), Czechia (ended), France (ended).
Therapeutic area(s): Diseases [C] - Neoplasms [C04]
Gender: Female, Male. Age: 18-64 years, 65+ years. Enrolment: 109.
Status: Ended. Start date (EU): 2020-12-14. End date (EU): 2025-02-06. End date: 2025-11-19. Decision date: 2023-06-13. Results received: No. Last updated: 2025-03-27.
Decision dates by country: CZ: 2023-06-15, RO: 2023-07-17, FR: 2023-06-21, PL: 2023-07-17, ES: 2023-06-13

Condition(s): Advanced Hepatocellular Carcinoma
Product: OPDIVO 10 mg/mL concentrate for solution for infusion., Relatlimab

Primary endpoint: Overall response rate (ORR) assessed by blinded independent central review (BICR) using Response Evaluation Criteria in Solid Tumors (RECIST) v1.1
Endpoint(s): Incidence of Adverse Events (AEs), Serious Adverse Events (SAEs), death and AEs leading to discontinuation, Incidence of clinically significant changes in clinical laboratory results: Hematology, Clinical Chemistry and Urinalysis tests, Disease control rate (DCR), Duration of response (DOR) and Progression-free survival assessed by BICR per RECIST v1.1, ORR, DCR, DOR and PFS assessed by investigator per RECIST v1.1, Overall survival (OS)

Source: https://euclinicaltrials.eu/ctis-public/view/2023-503519-13-00